EU clinical trial 2024-520202-19-00: A Phase 2a, Randomized, Double-Blind, Placebo-Controlled Study Evaluating the Safety, Tolerability, Pharmacokinetics, and Pharmacodynamics of Orziloben (NST-6179) in Subjects with Intestinal Failure-Associated Liver Disease (IFALD)
Protocol code: NST-6179-02
Sponsor: NorthSea Therapeutics B.V. (Pharmaceutical company). Phase: Therapeutic exploratory (Phase II). Countries: Belgium (ended), Denmark (not authorised), France (ended).
Therapeutic area(s): Diseases [C] - Digestive System Diseases [C06]
Gender: Female, Male. Age: 0-17 years, 18-64 years, 65+ years. Enrolment: 6.
Status: Ended. Start date (EU): 2025-08-19. End date (EU): 2026-05-04. End date: 2026-05-05. Decision date: 2025-06-18. Results received: No. Last updated: 2026-06-16.
Decision dates by country: BE: 2025-06-18, DK: 2025-06-18, FR: 2025-06-18

Condition(s): Subjects with Intestinal Failure-Associated Liver Disease (IFALD)
Product: Orziloben (NST-6179), The dosage form of the NST-6179 placebo oral solution is a clear colourless to light yellow oral solution

Primary endpoint: Part A: Safety and tolerability assessments will include, but not be limited to, subject-reported adverse events (AEs), blood and urine laboratory parameters, vital sign measurements, electrocardiograms (ECGs), physical examinations, and percentage of subjects discontinuing due to treatment-emergent adverse events (TEAEs)., Part A: Pharmacokinetic parameters will include, but not be limited to, area under the concentration-time curve from time 0 to last measurable concentration (AUC0-last), maximum observed concentration (Cmax), and time to reach Cmax (Tmax) on Day 1 and Day 14., Part B: Safety and tolerability assessments will include, but not be limited to, subject-reported AEs, blood and urine laboratory parameters, vital sign measurements, ECGs, physical examinations, and percentage of subjects discontinuing due to TEAEs., Part B: Pharmacokinetic parameters will include AUC0-last, Cmax, and Tmax on Day 1 and Day 28.

Source: https://euclinicaltrials.eu/ctis-public/view/2024-520202-19-00